EU clinical trial 2024-518724-72-00: PROgnostic value of precision medicine in patients with Myocardial Infarction and non-obStructive coronary artEries: the PROMISE study
Protocol code: PROMISE
Sponsor: Fondazione Policlinico Universitario Agostino Gemelli IRCCS (Hospital/Clinic/Other health care facility). Phase: Therapeutic use (Phase IV). Countries: Italy (ended).
Therapeutic area(s): Diseases [C] - Cardiovascular Diseases [C14]
Gender: Female, Male. Age: 18-64 years, 65+ years. Enrolment: 145.
Status: Ended. Start date (EU): 2021-09-02. End date (EU): 2025-06-30. Decision date: 2024-11-26. Results received: Yes. Last updated: 2024-11-26.

Condition(s): Myocardial infarction with non-obstructive coronary arteries (MINOCA)
Product: WARFARIN, LYSINE ASPIRIN, CLOPIDOGREL, ACETYLSALICYLIC ACID, ATORVASTATIN, DILTIAZEM, BISOPROLOL, ACETYLCHOLINE CHLORIDE, GLYCERYL TRINITRATE, RAMIPRIL

Primary endpoint: Angina status and quality of life (evaluated using the Seattle Angina Questionnaire [SAQ]) at 1-year follow-up in patients with MINOCA
Endpoint(s): Rates of major adverse cardiovascular events (MACE; composite of all-cause mortality; re-hospitalization for myocardial infarction, stroke or heart failure; repeated coronary angiography) at 1-year follow-up in MINOCA patients, Healthcare primary and secondary related-costs (including costs for tests, procedures and outpatient visits or medicines) and socioeconomic burden of MINOCA patients, Ability of different circulating biomarkers (ET-1, NPY, CRP, sCD40L and miRNA [miR-16, miR-26a, miR-145, miR-222, miR-155-5p, miR-483-5p and miR-451]) as diagnostic biomarker and stratification tool for specific causes of MINOCA, Ability of CMR in evaluating different mechanisms of MINOCA and their prognostic value

Source: https://euclinicaltrials.eu/ctis-public/view/2024-518724-72-00